EU clinical trial 2023-506213-21-00: Oral Antibiotic Outpatient Therapy vs. Placebo in the Treatment of Uncomplicated Acute Appendicitis: a Randomized Double-blind Placebo-controlled Noninferiority Trial APPAC IV
Protocol code: APPAC IV
Sponsor: Turku University Hospital (Hospital/Clinic/Other health care facility). Phase: Therapeutic use (Phase IV). Countries: Finland (authorised, recruitment pending).
Therapeutic area(s): Diseases [C] - Digestive System Diseases [C06]
Gender: Female, Male. Age: 18-64 years. Enrolment: 498.
Status: Authorised, recruitment pending. Decision date: 2023-10-23. Results received: No. Last updated: 2023-12-01.

Condition(s): Uncomplicated acute appendicitis
Product: Active investigational medicinal product (imp) contains 400 mg of moxifloxacin (1 x 400 mg tablet). moxifloxacin 400 mg tablets, which are authorized medicinal products, are sourced from legal supply chain of medicinal products at eu and used for preparation of the active imp. tablets are masked by over encapsulation with hard gelatine capsule, 1 x 400 mg in a capsule to maintain blinding. matching placebo imp capsule are prepared containing microcrystalline cellulose., MOXIFLOXACIN

Primary endpoint: The primary outcome is 30-day treatment success defined as resolution of acute appendicitis resulting in discharge from the hospital without appendectomy during the 30-day follow-up
Endpoint(s): Secondary endpoints include post-intervention complications (Clavien-Dindo classification), late recurrence of acute appendicitis after the 30-day follow-up, duration of hospital stay in hours, admission to hospital and reason for admission, readmissions to emergency department or hospitalization, VAS pain scores, quality of life (QOL, EQ-5D-5L), sick leave and overall treatment and societal costs

Source: https://euclinicaltrials.eu/ctis-public/view/2023-506213-21-00